EU clinical trial 2024-512412-22-00: A Phase III study to evaluate the efficacy of INM004 (Shiga antitoxin) in pediatric patients with Hemolytic Uremic Syndrome associated to infection by Shiga toxin-producing Escherichia coli
Protocol code: CT-INM004-04
Sponsor: Chemo Research S.L., Inmunova S.A. (Pharmaceutical company, Industry). Phase: Therapeutic confirmatory (Phase III). Countries: Italy (ongoing, recruiting), Netherlands (authorised, recruitment pending), Germany (ongoing, recruiting), Ireland (authorised, recruiting), Belgium (ongoing, recruiting), Romania (ongoing, recruiting), Spain (authorised, recruiting), France (ongoing, recruiting).
Therapeutic area(s): Diseases [C] - Bacterial Infections and Mycoses [C01]
Gender: Female, Male. Age: 0-17 years. Enrolment: 202.
Start date (EU): 2025-06-24. Decision date: 2024-10-04. Results received: No. Last updated: 2026-06-24.
Decision dates by country: BE: 2024-10-07, ES: 2024-10-04, NL: 2024-10-07, IE: 2024-10-09, DE: 2024-10-09, RO: 2024-10-09, IT: 2024-10-08, FR: 2024-10-07

Condition(s): Hemolytic Uremic Syndrome
Product: Sodium Chloride 0.9% PLACEBO INM004 solution for injection (Placebo), is a sterile normal saline solution packaged in glass vials containing sodium chloride at 0.9%, for administration by intravenous infusion., ANTI SHIGA TOXIN

Primary endpoint: Time to recovery of renal function during the acute phase. Defined as time (days) to achieve a GFR greater than or equal to the LLN (according to age, height, and sex) and a sCr less than or equal to the ULN (according to age and sex) measured in the absence of dialysis within the 28-day follow-up period.
Endpoint(s): Recovery of kidney function at the short-term - Proportion of subjects with GFR ≥ LLN of reference (according to age, height, and sex) and sCr ≤ ULN of reference (according to age and sex) measured in the absence of dialysis, at day 90., MAKE 90 - Proportion of subjects meeting any of the following criteria at day 90: death, dialysis requirement after 24 h post-randomization, dialysis for more than 10 days, or persistent decline in renal function (no recovery of expected GFR according to age, height, and sex)., Dialysis for more than 10 days - Proportion of dialyzed subjects requiring more than 10 days of dialysis., Incidence of dialysis. - Proportion of subjects requiring dialysis after 24 h post-randomization., Mortality. - Proportion of subjects who die due to any cause.

Source: https://euclinicaltrials.eu/ctis-public/view/2024-512412-22-00